EU clinical trial 2024-513459-34-00: A prospective controlled trial to evaluate safety and efficacy of in vitro expanded recipient regulatory T cell therapy and tocilizumab together with donor bone marrow infusion in HLA-mismatched living donor kidney transplant recipients (Trex)
Protocol code: Trex001
Sponsor: Medical University Of Vienna (Educational Institution). Phase: Phase I and Phase II (Integrated)- Other. Countries: Austria (ongoing, recruitment ended).
Therapeutic area(s): Diseases [C] - Immune System Diseases [C20]
Gender: Female, Male. Age: 18-64 years, 65+ years. Enrolment: 24.
Status: Ongoing, recruitment ended. Start date (EU): 2019-04-24. Decision date: 2024-05-31. Results received: No. Last updated: 2024-05-31.

Condition(s): Kidney transplantation
Product: Expanded Tregs_04, RoActemra 162 mg solution for injection in pre-filled syringe.

Primary endpoint: Co-primary endpoint 1 (safety) is defined as incidence of GVHD, impaired graft function [eGFR <35mL/min/1.73m2] or patient death, whichever occurs first, within 12 months post-transplant., Co-primary endpoint 2 (efficacy) is defined as the individual peak chimerism levels within the first month post-transplant.
Endpoint(s): To demonstrate that the study protocol allows the initiation of a step-wise reduction of immunosuppression up to a point when patients receive drug monotherapy., To gain insight as to whether the study protocol leads to detectable changes in the immune system indicative of pro-tolerogenic immune modulation., To assess the frequency of biopsy-proven acute rejection episodes., To assess the frequency of subclinical rejection episodes on surveillance biopsies., To assess kidney graft function., To assess the area-under-the-curve (AUC) of chimerism.

Source: https://euclinicaltrials.eu/ctis-public/view/2024-513459-34-00